EU clinical trial 2023-507415-35-00: A Phase III, Randomized, Double-Blind, Placebo-Controlled Study to Demonstrate the Efficacy and Safety of Tildrakizumab in Anti-TNF Experienced Subjects with Active Psoriatic Arthritis I (INSPIRE 1)
Protocol code: TILD-19-07
Sponsor: Sun Pharmaceutical Industries Limited (Pharmaceutical company). Phase: Therapeutic confirmatory (Phase III). Countries: Czechia (ended), Germany (ended), Estonia (ended), Spain (ended), Slovakia (ended), Italy (ended), Poland (ended).
Therapeutic area(s): Diseases [C] - Skin and Connective Tissue Diseases [C17]
Gender: Female, Male. Age: 18-64 years, 65+ years. Enrolment: 204.
Status: Ended. Start date (EU): 2021-01-15. End date (EU): 2025-12-19. End date: 2025-12-22. Decision date: 2024-05-31. Results received: No. Last updated: 2025-04-10.
Decision dates by country: PL: 2024-06-21, ES: 2024-06-04, IT: 2024-07-01, DE: 2024-05-31, CZ: 2024-06-04, SK: 2024-05-31, EE: 2024-05-31

Condition(s): Psoriatic Arthritis
Product: Ilumetri 100 mg solution for injection in pre-filled syringe, tildrakizumab placebo solution for injection in pre-filled syringe

Primary endpoint: The proportion of subjects who achieve ACR20 at Week 24

Source: https://euclinicaltrials.eu/ctis-public/view/2023-507415-35-00